EU clinical trial 2024-511722-31-00: A Phase 1b/2 Open-Label, Randomized Study of 2 Combinations of Isocitrate Dehydrogenase (IDH) Mutant Targeted Therapies Plus Azacitidine: Oral AG-120 Plus Subcutaneous Azacitidine and Oral AG-221 Plus SC Azacitidine in Subjects With Newly Diagnosed Acute Myeloid Leukemia Harboring an IDH1 or an IDH2 Mutation, Respectively, Who Are Not Candidates to Receive Intensive Induction Chemotherapy
Protocol code: AG-221-AML-005
Sponsor: Celgene Corp. (Pharmaceutical company). Phase: Phase I and Phase II (Integrated)- Other. Countries: Germany (ended), France (ongoing, recruitment ended), Netherlands (ended), Italy (ended).
Therapeutic area(s): Diseases [C] - Hemic and Lymphatic Diseases [C15]
Gender: Female, Male. Age: 18-64 years, 65+ years. Enrolment: 70.
Start date (EU): 2016-11-29. Decision date: 2024-07-18. Results received: No. Last updated: 2026-01-23.
Decision dates by country: FR: 2024-07-19, IT: 2024-07-22, NL: 2024-08-14, DE: 2024-07-18

Condition(s): Acute Myeloid Leukemia (AML)
Product: Enasidenib Mesilate, Enasidenib Mesilate, Ivosidenib, Vidaza 25 mg/ml powder for suspension for injection

Primary endpoint: Ph Ib Dose Finding and AG-120 Expansion: 1. Recommended Combination Dose - Review of dose-limiting toxicities (DLTs), safety, PK / pharmacodynamic, biomarker, and preliminary efficacy data by DRT., 2. Safety / tolerability - Type, frequency, seriousness and severity of AEs, and relationship of AEs to study treatment., 3. Overall Response Rate (as assessed by the investigator)- Rate of CR + CRi + CRp + MLFS + PR according to modified IWG AML response criteria (Appendix F).
Endpoint(s): Ph Ib Dose Finding and AG-120 Expansion: 1. Overall Response Rate (as assessed by the investigator) - Rate of CR + CRi + CRp + MLFS + PR according to modified IWG AML response criteria (Appendix F)., 2. Sponsor Derived CR and CRh - Rate of CR/ CRh and CR + CRh based on laboratory data, 3. Pharmacodynamics (Exploratory) - To evaluate the pharmacodynamics of oral AG-120 + SC azacitidine and oral AG-221 + SC azacitidine when administered in combination in this population., 4. Event-Free Survival - Time from randomization to documented morphologic relapse, progression according to modified IWG AML response criteria (Appendix F), or death from any cause, whichever occurs first., 5. Safety / tolerability - Type, frequency, seriousness and severity of AEs, and relationship of AEs to study treatment., 6. Complete remission rate - Rate of CR according to modified IWG AML response criteria (Appendix F)., 7. Sponsor Derived CR - Rate of CR based on laboratory data, 8. Sponsor Derived CR and CRh - Rate of CR +CRh based on laboratory data, 9. Hematologic improvement rate - Rate of HI-N + HI-P + HI-E according to IWG MDS HI criteria (Appendix G)., 10. Duration of Response - Time from the first documented MLFS/CR/CRi/CRp/PR to documented morphologic relapse, progression according to modified IWG AML response criteria (Appendix F), or death due to any cause, whichever occurs first, 11. Time to response - Time from first dose of study drug to first documented CR/CRi/CRp/MLFS/PR according to modified IWG AML response criteria (Appendix F), 12. Time to sponsored assessed CR and CRh - Time from first dose of study drug to first documented CR / CRh, 13. Duration of sponsor assessed CR and CRh - Time from the first documented CR/CRh to documented morphologic relapse, progression, 14. Overall Survival - Time from randomization to death due to any cause., 15. One-year survival - The probability of survival at 1 year from randomization, 16. PK parameters - Plasma concentrations and pharmacokinetic parameters of AG-120 or AG-221., 17. HRQoL outcomes - European Organization for Research and Treatment of Cancer Quality-of-Life questionnaire (EORTC QLQ-C30) (Appendix N) and EuroQoL Group EQ-5D-5L instrument (Appendix O), 18. Healthcare resource utilization (Exploratory) - Information about all resource use (eg, hospitalization), 19. Days alive and out of hospital (Exploratory)- Measurement of days without hospitalization, 20. Pharmacodynamics (Exploratory) - Evaluation of 2-HG and α-KG levels in plasma and/or bone marrow. Evaluate methylation in PB and/or transcription in BM., 21. Correlative studies (Exploratory) - Evaluation of molecular, cellular and metabolic markers which may be predictive of antitumor activity and/or resistance. Evaluation of minimal residual disease (MRD) by flow cytometry and by IDH2 variant allele fraction (VAF) in blood and bone marrow cells. Evaluation of changes in cellular differentiation and changes in histone and deoxyribonucleic acid (DNA) methylation profiles of IDH2 mutated leukemic cells., 21. Correlative studies (Exploratory) - Evaluation of molecular, cellular and metabolic markers which may be predictive of antitumor activity and/or resistance. Evaluation of minimal residual disease (MRD) by flow cytometry and by IDH2 variant allele fraction (VAF) in blood and bone marrow cells. Evaluation of changes in cellular differentiation and changes in histone and deoxyribonucleic acid (DNA) methylation profiles of IDH2 mutated leukemic cells.

Source: https://euclinicaltrials.eu/ctis-public/view/2024-511722-31-00